EU clinical trial 2024-512786-13-00: A Randomized, Multicentre, Double-blind, two Parallel Group, Clinical Phase III Trial for Comparing the Efficacy and Tolerability of a combination IM product of Diclofenac and Thiocolchicoside vs. Diclofenac (Voltaren®) IM in patients with acute moderate to severe low back pain
Protocol code: DITH/VER
Sponsor: Verisfield Single Member S.A. (Pharmaceutical company). Phase: Therapeutic confirmatory (Phase III). Countries: Greece (ended).
Therapeutic area(s): Diseases [C] - Musculoskeletal Diseases [C05]
Gender: Female, Male. Age: 18-64 years, 65+ years. Enrolment: 140.
Status: Ended. Start date (EU): 2024-12-13. End date (EU): 2025-06-05. Decision date: 2024-08-28. Results received: Yes. Last updated: 2024-08-28.

Condition(s): Acute moderate to severe low back pain
Product: Diclofenac+Thiocolchicoside/ Verisfield solution for injection, Voltaren 75 mg/3 ml ενέσιμο διάλυμα

Primary endpoint: Mean change in VAS from baseline to 3 hours after administration
Endpoint(s): Mean change in VAS from baseline to 1 hour after administration, Proportion of patients with >30% reduction in pain intensity from baseline at 3 hours, Proportion of patients with >30% reduction in pain intensity from baseline at 1 hour, Mean change of Finger-to floor distance from baseline to 3 hours post administration, Mean change of Finger-to floor distance from baseline to 1 hour post administration, Proportion of patients withdrawn for reasons related to treatment and the proportion of patients experiencing adverse events

Source: https://euclinicaltrials.eu/ctis-public/view/2024-512786-13-00